EU clinical trial 2025-523475-33-00: Caffeine Administration for Preterms: Pharmacokinetics, Utilization and Correlation Inhibiting Nociception Outcome
Protocol code: CAPPUCINO-2025
Sponsor: Masarykova Univerzita (Educational Institution). Phase: Therapeutic use (Phase IV). Countries: Czechia (ongoing, recruiting).
Therapeutic area(s): Diseases [C] - Congenital, Hereditary, and Neonatal Diseases and Abnormalities [C16]
Gender: Female, Male. Age: 0-17 years. Enrolment: 200.
Status: Ongoing, recruiting. Start date (EU): 2026-05-18. Decision date: 2026-02-09. Results received: No. Last updated: 2026-04-22.

Condition(s): Primary apnea in preterms newborns
Product: Peyona 20 mg/ml solution for infusion and oral solution

Primary endpoint: a) Exploration of observed caffeine concentration levels in groups of preterm newborns receiving caffeine therapy, stratified by treatment response as defined by the duration of IRS evaluated on Day 11 and at 36 weeks of postmenstrual age (PMA).
Endpoint(s): 1. a) Proportion of preterm newborns in whom the concentrations of caffeine and paraxanthine can be reliably measured from saliva samples., 2. a) Salivary caffeine concentrations over time b) Relationship between caffeine dose and concentration over time., 3. a) Relationship between salivary caffeine concentrations and: • Frequency (Apnea of Prematurity events per 24 hours) and severity of apneic episodes (detail in Section 6.7.3.) • The need for respiratory support, considering its duration and type • Time to successful withdrawal of caffeine therapy, 4. a) Incidence of prematurity-related complications: BPD, ROP, PDA, periventricular hemorrhage/intraventricular hemorrhage (PVH/IVH), periventricular leukomalacia (PVL), posthemorrhagic hydrocephalus (PHH), neonatal seizures, and others., 5. a) Evaluation of pain assessment scores (COMFORTneo Scale) and vital function parameters (heart rate, blood pressure) in relation to concentration and exposure duration., 6. a) Comparison of the incidence and severity of adverse events of special interest (AESI) related to caffeine therapy in relation to caffeine concentration levels: • CVS: Tachycardia (for definition see Section 6.7.2) • CNS: Convulsion, brain injury, irritability, jitters, shaking • GIT: Feeding intolerance, necrotizing enterocolitis • Investigations: Urine output increased, Exploratory endpoints 2. a) CYP1A2 metabolic activity (caffeine/paraxanthine ratio in saliva) in both GA subgroups and correlation with caffeine therapy duration. b) Evaluation of the analgesic effect of caffeine in relation to CYP1A2 metabolic activity. c) Relationship between CYP1A2 metabolic phenotype and treatment efficacy or caffeine-related adverse events (e.g., tachycardia, feeding intolerance).

Source: https://euclinicaltrials.eu/ctis-public/view/2025-523475-33-00